EU clinical trial 2023-506952-26-01: Optimizing Lymph Node Staging in Esophageal Cancer with USPIO-enhanced MRI
Sponsor: Amsterdam UMC (Hospital/Clinic/Other health care facility). Phase: Therapeutic exploratory (Phase II). Countries: Netherlands (authorised, recruitment pending).
Therapeutic area(s): Diseases [C] - Neoplasms [C04]; Analytical, Diagnostic and Therapeutic Techniques and Equipment [E] - Investigative Techniques [E05]; Diseases [C] - Digestive System Diseases [C06]; Analytical, Diagnostic and Therapeutic Techniques and Equipment [E] - Diagnosis [E01]
Gender: Female, Male. Age: 18-64 years, 65+ years. Enrolment: 1.
Status: Authorised, recruitment pending. Decision date: 2025-07-31. Results received: No. Last updated: 2025-07-31.

Condition(s): Esophageal cancer
Product: Ferrotran Lyophilisate

Primary endpoint: Observer’s qualitative assessment of image quality for evaluation of lymph node metastases on USPIO-enhanced MR, compared to PET-CT images, Time required for observers to assess USPIO-enhanced MRI, compared to standard PET-CT, in minutes, Patient questionnaire for perceived burden of undergoing USPIO-enhanced MRI, compared to PET-CT, Accuracy (sensitivity, specificity, positive /negative predictive value, and likelihood ratio) of detecting lymph node metastases on USPIO-enhanced MRI, compared to PET-CT, with pathological assessment as reference standard, Lymph node size, shape, number, intensity, location, and fibrotic characteristics
Endpoint(s): Complications, (S)AEs, SUSARs, and toxicity from USPIO-infusion, Time intervals between all study and standard of care procedures in days, Accuracy (sensitivity, specificity, positive /negative predictive value, and likelihood ratio) of the proposed lymph node scoring system for metastatic suspicion on USPIO-enhanced MRI

Source: https://euclinicaltrials.eu/ctis-public/view/2023-506952-26-01